EU clinical trial 2024-511309-47-00: A Phase 2 study to evaluate the efficacy and safety of selinexor monotherapy in subjects with JAK inhibitor-naïve myelofibrosis and moderate thrombocytopenia.
Protocol code: XPORT-MF-044
Sponsor: Karyopharm Therapeutics Inc. (Pharmaceutical company). Phase: Therapeutic exploratory (Phase II). Countries: France (ongoing, recruiting), Germany (ongoing, recruiting), Spain (ongoing, recruiting), Denmark (authorised, recruiting), Netherlands (ongoing, recruiting), Czechia (authorised, recruiting), Romania (ongoing, recruiting), Bulgaria (ongoing, recruiting), Greece (ongoing, recruiting), Poland (ongoing, recruiting), Italy (ongoing, recruiting), Belgium (ongoing, recruiting), Hungary (authorised, recruiting).
Therapeutic area(s): Diseases [C] - Hemic and Lymphatic Diseases [C15]
Gender: Female, Male. Age: 18-64 years, 65+ years. Enrolment: 38.
Start date (EU): 2024-07-17. Decision date: 2024-06-10. Results received: No. Last updated: 2026-06-10.
Decision dates by country: RO: 2024-06-17, PL: 2024-06-14, NL: 2024-06-10, ES: 2024-06-11, DE: 2024-06-12, BG: 2024-06-14, IT: 2024-06-14, BE: 2024-06-12, GR: 2024-06-17, FR: 2024-06-12, HU: 2024-06-12, DK: 2024-06-11, CZ: 2024-06-13

Condition(s): moderate thrombocytopenia, JAK inhibitor-naïve myelofibrosis
Product: APREPITANT, Jakavi 10 mg tablets, NETUPITANT, SELINEXOR, Jakavi 5 mg tablets, PALONOSETRON, PACRITINIB, ONDANSETRON

Primary endpoint: Proportion of patients with SVR35 at Week 24 as measured by MRI or CT scan by Investigator assessment
Endpoint(s): Abs-TSS from baseline to Week 24 as measured by the MFSAF v4.0 a, Proportion of patients with SVR35 at Week 48 as measured by MRI or CT scan by Investigator assessment, Abs-TSS from baseline to Week 48 as measured by the MFSAF v4.0a, PFS as defined in the SAP, OS defined as the time interval from the start of selinexor dosing to the date of death due to any cause, Proportion of patients with SVR35 in the study as measured by MRI or CT scan at any time point, TD vs TI, driver mutation (JAK2, CALR, MPL), high risk mutations (ASXL1, EZH2, IDH1/2, SRSF2, or U2AF1), Incidence and severity of TEAEs including TRAEs, and SAEs, PK endpoints including but not limited to AUC, maximal concentration (Cmax), and time at which Cmax is achieved (tmax), Extent and duration of receptor occupancy or XPO1 mRNA induction, Proportion of patients with at least a 1-grade decrease in bone marrow fibrosis at any point in the study, Proportion of patients with hemoglobin stabilization at any timepoint • Change in total number of RBC transfusion units between a 3-month period prior to start of study, 3-month period after start of study, and the periods between Week 12 and 24 and Week 24-48 in all patients that remain on study treatment. • Rate of RBC transfusion over the first 24 wks of treatment and the second 24 wks of treatment • Conversion from RBC transfusion dependence at baseline to independence

Source: https://euclinicaltrials.eu/ctis-public/view/2024-511309-47-00